EU clinical trial 2023-504639-42-00: Open-label, Multi-centre, Non-Inferiority study of safety and immunogenicity of BIMERVAX as heterologous booster for the prevention of coronavirus disease 2019 (COVID-19) in adolescents from 12 years to less than 18 years of age.
Protocol code: HIPRA-HH-3
Sponsor: Hipra Scientific S.L. (Pharmaceutical company). Phase: Therapeutic exploratory (Phase II). Countries: Spain (ended).
Therapeutic area(s): Diseases [C] - Virus Diseases [C02]
Gender: Female, Male. Age: 0-17 years. Enrolment: 300.
Status: Ended. Start date (EU): 2023-05-26. End date (EU): 2025-09-09. Decision date: 2023-05-26. Results received: Yes. Last updated: 2025-07-11.

Condition(s): SARS-CoV-2 infection
Product: BIMERVAX emulsion for injection COVID-19 Vaccine (recombinant, adjuvanted)

Primary endpoint: Neutralisation titre against Omicron BA.1 measured as inhibitory concentration 50 (IC50) by PBNA and reported as log10 concentration for each individual sample and Geometric Mean Titre (GMT) for group comparison with HIPRA-HH-2 at Baseline and Day 14., Solicited local and systemic reactions through Day 7 after vaccination., Unsolicited local and systemic adverse events (AEs) through Day 28 after vaccination., Related adverse events (AEs) and all serious adverse events (SAEs) through the end of the study., Adverse event of special interest (AESI) through the end of the study., Related medically attended adverse events (MAAE) through the end of the study., Grade 2, Grade 3 and Grade 4 changes from Baseline in safety laboratory parameters through Day 14 after vaccination.

Source: https://euclinicaltrials.eu/ctis-public/view/2023-504639-42-00